EU clinical trial 2023-508784-68-00: A Randomized, Phase 2/3, Open-Label Study to Investigate the Efficacy and Safety of RP2 in Combination with Nivolumab versus Ipilimumab in Combination with Nivolumab in Immune Checkpoint Inhibitor-Naïve Adult Patients with Metastatic Uveal Melanoma
Protocol code: RP2-202
Sponsor: Replimune Inc. (Pharmaceutical company). Phase: Phase II and Phase III (Integrated). Countries: Germany (authorised, recruitment pending), Italy (authorised, recruitment pending), France (authorised, recruitment pending), Spain (authorised, recruitment pending), Poland (authorised, recruitment pending).
Therapeutic area(s): Diseases [C] - Neoplasms [C04]
Gender: Female, Male. Age: 18-64 years, 65+ years. Enrolment: 98.
Status: Authorised, recruitment pending. Decision date: 2025-12-23. Results received: No. Last updated: 2026-01-12.
Decision dates by country: FR: 2026-01-12, DE: 2026-01-08, IT: 2026-01-12, ES: 2025-12-23, PL: 2026-01-04

Condition(s): metastatic uveal melanoma
Product: YERVOY 5 mg/ml concentrate for solution for infusion, RP2, OPDIVO 10 mg/mL concentrate for solution for infusion., RP2

Primary endpoint: OS, defined as the time from randomization to death from any cause, PFS, defined as the time from randomization to first evidence of disease progression (which is subsequently confirmed) as assessed by BICR per RECIST 1.1 or death from any cause
Endpoint(s): ORR, defined as the proportion of patients with a confirmed best overall response of CR or PR, as assessed by BICR per RECIST 1.1, DOR, defined as the time from onset of response to disease progression (which is subsequently confirmed) or death in patients who achieve either a CR or PR, as assessed by BICR per RECIST 1.1, DCR, defined as the proportion of patients with a confirmed best overall response of CR, PR, or Stable Disease (SD), as assessed by BICR per RECIST 1.1, CBR, defined as the percentage of patients who achieve a best confirmed response of CR, PR, or SD for at least 24 weeks, as assessed by BICR per RECIST 1.1, DOCB, defined as the time from randomization to disease progression or death due to any cause (whichever occurs first) in patients who achieve a best confirmed response of CR, PR, or SD for at least 24 weeks, as assessed by BICR per RECIST 1.1, Incidence of treatment-emergent adverse events (TEAEs) including serious adverse events (SAEs) in each study arm, Incidence of imAEs in each study arm

Source: https://euclinicaltrials.eu/ctis-public/view/2023-508784-68-00